EU clinical trial 2024-519248-34-00: A Phase II, Multicentre, Randomised, Double-blind, Parallel-Group, Placebo controlled Study to Evaluate the Efficacy and Safety of IPN10200 as a Treatment for Cervical Dystonia in Adult Participants
Protocol code: CLIN-10200-457
Sponsor: Ipsen Innovation (Pharmaceutical company). Phase: Therapeutic exploratory (Phase II). Countries: Czechia (ongoing, recruiting), Germany (ongoing, recruiting), Poland (ongoing, recruiting), France (ongoing, recruiting), Italy (ongoing, recruiting), Spain (ongoing, recruiting).
Therapeutic area(s): Diseases [C] - Musculoskeletal Diseases [C05]
Gender: Female, Male. Age: 18-64 years, 65+ years. Enrolment: 94.
Status: Ongoing, recruiting. Start date (EU): 2025-06-17. Decision date: 2025-05-12. Results received: No. Last updated: 2026-07-15.
Decision dates by country: FR: 2025-05-14, PL: 2025-05-25, DE: 2025-05-12, IT: 2025-07-24, CZ: 2025-05-20, ES: 2025-05-14

Condition(s): Cervical Dystonia
Product: IPN10200, Placebo of IPN10200

Primary endpoint: Change from Baseline in the Toronto Western Spasmodic Torticollis Rating Scale (TWSTRS) total score. [Time frame: at week 4]
Endpoint(s): Change from Baseline in the TWSTRS total score at all other scheduled timepoints post injection until Week 36. [Time Frame: At all timepoints post injection until Week 36.], Change from Baseline in the TWSTRS-Pain Subscale. The TWSTRS pain subscale consists of three patient-rated items that assess the participants usual, worst and best pain from the preceding week, and the subscore has a maximum of 20. [Time Frame: At all timepoints post injection until Week 36.], Change from baseline in the daily Numerical Rating Scale (NRS) score [Time Frame: Averaged over every 7-day period until the Week 4 visit], Time to onset of pain reduction Defined as the duration from the administration of the study injection to the first recorded instance of a minimum 2-point decrease in the Numeric Rating Scale (NRS) score. [Time Frame: From study injection to first timepoint at which at least 2-point reduction is observed in NRS score], Time to return of symptoms in responders (time from treatment to loss of 80% of peak treatment effect) [Time Frame: From randomization until Week 36], Change from Baseline in the TWSTRS-Disability Subscale. The TWSTRS disability subscale assesses the effect that Cervical Dystonia (CD) has on the participant’s daily activities and the subscore has a maximum of 30 and consists of six items. [Time Frame: At all timepoints post injection until Week 36.], Change from Baseline in the TWSTRS-Severity Subscale. The TWSTRS severity subscale rates the maximal excursion of the torticollis (degree of tilt or rotation), elevation, range of motion, etc. This severity subscore has a maximum subtotal of 35 and consists of 11 items. [Time Frame: At all scheduled timepoints post injection until Week 36], Change from baseline in Clinical Global Impression of Severity (CGI-S) score. [Time Frame: At all timepoints post injection until Week 36.], Clinical Global Impression of Change (CGI-C) score [Time Frame: At all timepoints post injection until Week 36.], Change from baseline in Patients' Global Impression of Severity (PGI-S) score [Time Frame: At all timepoints post injection until Week 36], Patients' Global Impression of Change (PGI-S) score [Time Frame: At all timepoints post injection until Week 36], Change from Baseline in the Cervical Dystonia Impact Profile (CDIP-58) total score. [Time Frame: At all timepoints post injection until Week 36], Percentage of participants experiencing any Adverse Event (AEs) including treatment emergent adverse events (TEAEs), serious adverse events (SAEs), adverse event of special interest (AESI) and AE leading to treatment discontinuation. [Time Frame: From baseline to Week 36.], Percentage of participants with clinically significant changes from baseline in Laboratory Parameters Clinically significant change in laboratory parameters will be reported. The clinical significance will graded by the investigator. [Time Frame: At all timepoints post injection until Week 36], Percentage of Participants With Clinically Significant Changes from baseline in Vital Signs Clinically significant changes in vital signs will be reported. The clinical significance will be graded by the investigator. [Time Frame: At all timepoints post injection until Week 36], Percentage of participants with clinically significant change from baseline in focused neurological/physical examinations. [Time Frame: At all timepoints post injection until Week 36], Percentage of participants with clinically significant change from baseline in 12-lead Electrocardiogram (ECG) readings. [Time Frame: At all timepoints post injection until Week 36], Treatment-emergence of suicidal ideation/suicidal behaviour. The Columbia Suicide Severity Rating Scale (C-SSRS) will be used in this study for the evaluation of suicidal ideation and behaviour. [Time Frame: From baseline to Week 36.], Percentage of participants with Binding antibodies to IPN10200 [Time Frame: At all timepoints post injection until Week 36], Percentage of participants with neutralising antibodies to IPN10200. [Time Frame: At all timepoints post injection until Week 36]

Source: https://euclinicaltrials.eu/ctis-public/view/2024-519248-34-00